EU clinical trial 2025-523704-77-00: A randomized, double masked, placebo-controlled, multicenter, dose-range finding study to assess the efficacy and safety of FWY003 in patients with geographic atrophy secondary to age-related macular degeneration
Protocol code: CFWY003A12201
Sponsor: Novartis Pharma AG (Pharmaceutical company). Phase: Therapeutic exploratory (Phase II). Countries: Bulgaria (ongoing, recruiting), Romania (ongoing, recruiting), Germany (ongoing, recruiting), Czechia (ongoing, recruiting), Spain (ongoing, recruiting), Poland (ongoing, recruiting), Italy (ongoing, recruiting), Hungary (ongoing, recruiting), France (ongoing, recruiting).
Therapeutic area(s): Diseases [C] - Eye Diseases [C11]
Gender: Female, Male. Age: 18-64 years, 65+ years. Enrolment: 142.
Status: Ongoing, recruiting. Start date (EU): 2026-06-04. Decision date: 2026-05-04. Results received: No. Last updated: 2026-06-23.
Decision dates by country: CZ: 2026-05-04, FR: 2026-05-04, DE: 2026-05-05, HU: 2026-05-08, IT: 2026-05-06, RO: 2026-05-08, ES: 2026-05-08, PL: 2026-05-06, BG: 2026-05-08

Condition(s): Geographic atrophy secondary to age-related macular degeneration
Product: FWY003, FWY003, Placebo to FWY003, FWY003

Primary endpoint: Change of GA lesion area from Baseline to Month 18
Endpoint(s): Incidence and severity of ocular and non-ocular AEs, and systemic safety measures including physical examinations, vital signs, ECG and laboratory tests., Change in visual function in the study eye from Baseline through Month 18 as measured by: • Early treatment diabetic retinopathy study (ETDRS) (Regular Luminance) Best Corrected Visual Acuity (BCVA) • ETDRS Low Luminance Visual Acuity (LLVA) • Quantitative contrast sensitivity function (qCSF) under regular luminance • Low Contrast quantitative Visual Acuity (LCqVA) under regular luminance • LCqVA under low luminance • Proportion of participants with ≥15 letters loss from baseline, Change in area of total and partial ellipsoid zone (EZ) attenuation in the macula from Baseline through Month 18, Rate of change of GA lesion area (square-root transformed) in the study eye from Baseline through Month 18, Change of GA lesion area (square-root transformed) from Baseline through Month 00.

Source: https://euclinicaltrials.eu/ctis-public/view/2025-523704-77-00